EU clinical trial 2024-513586-39-00: A Randomised, Double-blind, Placebo-controlled, Phase III Study of Adjuvant Saruparib (AZD5305) in Patients with BRCAm Localised High-risk Prostate Cancer Receiving Radiotherapy with Androgen Deprivation Therapy (EvoPAR-Prostate02)
Protocol code: D9727C00001
Sponsor: AstraZeneca AB (Pharmaceutical company). Phase: Therapeutic confirmatory (Phase III). Countries: Austria (ongoing, recruiting), Sweden (ongoing, recruiting), Spain (ongoing, recruiting), France (ongoing, recruiting), Netherlands (ongoing, recruiting), Germany (ongoing, recruiting), Belgium (ongoing, recruiting), Finland (ongoing, recruiting), Hungary (ongoing, recruiting), Poland (ongoing, recruiting), Italy (ongoing, recruiting).
Therapeutic area(s): Diseases [C] - Male Urogenital Diseases [C12]
Gender: Male. Age: 18-64 years, 65+ years. Enrolment: 253.
Status: Ongoing, recruiting. Start date (EU): 2025-12-10. Decision date: 2025-11-12. Results received: No. Last updated: 2026-07-13.
Decision dates by country: HU: 2025-11-14, ES: 2025-11-17, NL: 2025-11-17, IT: 2025-11-17, FI: 2025-11-12, SE: 2025-11-12, FR: 2025-11-17, PL: 2025-11-15, AT: 2025-11-17, BE: 2025-11-12, DE: 2025-11-14

Condition(s): Prostate Cancer
Product: ZYTIGA 250 mg tablets, Placebo to match (PTM) AZD5305 film-coated tablets, ZYTIGA 500 mg film-coated tablets, Saruparib

Primary endpoint: MFS is defined as the time from randomisation until the date of first appearance of distant metastases, confirmed by standard clinical imaging [computed tomography (CT)/ magnetic resonance imaging (MRI) and bone scan, or prostate-specific membrane antigen-positron emission tomography (PSMA-PET)], as assessed by blinded independent central review (BICR) or death due to any cause.
Endpoint(s): OS is defined as the time from randomisation until the date of death due to any cause., MFS is defined as the time from randomisation until the date of distant metastases, confirmed by conventional imaging (CT/MRI and bone scan), or death due to any cause., MFS is defined as the time from randomisation until the date of distant metastases, confirmed by PSMA-PET imaging or death due to any cause., MFS is defined as the time from randomisation until the date of distant metastases, confirmed by standard clinical imaging (CT/MRI and bone scan or PSMA-PET), histology, or death due to any cause., Time from randomisation to PFS2 is defined as the time from randomisation to the earliest of progression [defined as radiographic progression, clinical progression, or prostate-specific antigen (PSA) progression] after initiation of first subsequent systemic treatment following the initial investigator-assessed progression or death. The date of second progression will be investigator assessed according to local standard clinical practice., Time to biochemical recurrence is defined as the time from randomisation to biochemical recurrence per Phoenix criteria., PCSS is defined as the time from randomisation until the date of death due to the underlying prostate cancer., TTDUS is defined as the time from randomisation to deterioration in EORTC-QLQ-PR25 (US) subscale scores., TTDPF is defined as the time from randomisation to deterioration in EORTC-QLQ-C30 Physical Function subscale scores, To assess the PK of saruparib in plasma either with or without abiraterone and explore the relationship between the PK concentration/parameters and selected endpoints (which may include pharmacodynamic parameters, efficacy, and/or safety).

Source: https://euclinicaltrials.eu/ctis-public/view/2024-513586-39-00